EU clinical trial 2025-525008-12-00: An open-label multiple dose safety, tolerability and exploratory efficacy clinical trial of PST-611 in patients with geographic atrophy secondary to age-related macular degeneration
Protocol code: PST-611-CT2
Sponsor: PulseSight Therapeutics (Pharmaceutical company). Phase: Therapeutic exploratory (Phase II). Countries: France (authorised, recruitment pending).
Therapeutic area(s): Diseases [C] - Eye Diseases [C11]
Gender: Female, Male. Age: 65+ years. Enrolment: 24.
Status: Authorised, recruitment pending. Decision date: 2026-06-25. Results received: No. Last updated: 2026-06-25.

Condition(s): Geographic atrophy secondary to age-related macular degeneration

Primary endpoint: • Ocular AEs and TEAEs (incl. SAEs) frequency and severity. • Findings at ophthalmic clinical examination, including slit lamp biomicroscopy and dilated ophthalmoscopy, intraocular pressure (IOP) and best corrected visual acuity (BCVA), color fundus photography (CFP) and Spectral Domain-Optical Coherence Tomography (SD-OCT).
Endpoint(s): • Change from Baseline (CFB) in Intraocular pressure (IOP) • CFB in ophthalmic clinical examination including slit lamp biomicroscopy and ophthalmoscopy • CFB in clinical assessment of color fundus photography (CFP) • CFB in clinical assessment of Spectral Domain-Optical Coherence Tomography (SD-OCT, CFB in best corrected visual acuity (BCVA), CFB in quantitative Contrast Sensitivity Function (qCSF) at normal luminance (Manifold Platform®) CFB in the area of retinal pigment epithelium (RPE) loss identified by deep learning-based analysis of SD-OCT CFB in the area of photoreceptor (PR) degeneration (also known as EZ layer loss) identified by deep learning-based analysis of SD-OCT

Source: https://euclinicaltrials.eu/ctis-public/view/2025-525008-12-00